EU clinical trial 2023-503516-32-00: A parallel group (2-arm), randomised, double-blind, 12-week trial to explore the efficacy and safety of MC2-25 cream and MC2-25 vehicle in women diagnosed with vulvar lichen sclerosus (VLS)
Protocol code: MC2-25-C3
Sponsor: Mc2 Therapeutics Limited (Pharmaceutical company). Phase: Therapeutic exploratory (Phase II). Countries: Denmark (ended).
Therapeutic area(s): Diseases [C] - Skin and Connective Tissue Diseases [C17]
Gender: Female. Age: 18-64 years, 65+ years. Enrolment: 40.
Status: Ended. Start date (EU): 2023-10-12. End date (EU): 2024-11-09. End date: 2024-11-10. Decision date: 2023-10-09. Results received: Yes. Last updated: 2024-08-26.

Condition(s): Vulvar lichen sclerosus (VLS)
Product: Same as test product, without activa substance

Primary endpoint: Mean change in weekly mean Worst Itch Numeric Rating Score (WI-NRS) recorded in the patient’s diary from Baseline to Week 12 for MC2-25 cream compared to MC2-25 vehicle.
Endpoint(s): Mean change in weekly mean Worst Pain Numeric Rating Score (WP-NRS) recorded in the patient’s diary from Baseline to Week 12 for MC2-25 cream compared to MC2-25 vehicle., Percentage of patients obtaining a ≥4-point improvement in weekly mean WI-NRS recorded in the patient’s diary from Baseline to Week 12 for MC2-25 cream compared to MC2-25 vehicle., Percentage of patients obtaining a ≥4-point improvement in weekly mean WP-NRS recorded in the patient’s diary from Baseline to Week 12 for MC2-25 cream compared to MC2-25 vehicle., Percentage of patients obtaining a ≥3-point improvement in weekly mean WI-NRS recorded in the patient’s diary from Baseline to Week 12 for MC2-25 cream compared to MC2-25 vehicle., Percentage of patients obtaining a ≥3-point improvement in weekly mean WP-NRS recorded in the patient’s diary from Baseline to Week 12 for MC2-25 cream compared to MC2-25 vehicle., Change in Skindex-29 domains from baseline to week 12 for MC2-25 cream compared to MC2-25 vehicle.

Source: https://euclinicaltrials.eu/ctis-public/view/2023-503516-32-00